EU clinical trial 2023-509303-32-00: Phase 1/2 Dose-Escalation Study to Evaluate the Safety, Tolerability, and Efficacy of a Single Intravenous Infusion of SPK-3006 in Adults with Late-Onset Pompe Disease
Protocol code: XE45632
Sponsor: Genentech Inc. (Pharmaceutical company). Phase: Phase I and Phase II (Integrated)- First administration to humans. Countries: Germany (authorised, recruiting).
Therapeutic area(s): Diseases [C] - Congenital, Hereditary, and Neonatal Diseases and Abnormalities [C16]; Diseases [C] - Nutritional and Metabolic Diseases [C18]
Gender: Female, Male. Age: 18-64 years. Enrolment: 2.
Status: Authorised, recruiting. Start date (EU): 2021-10-19. Decision date: 2024-09-20. Results received: No. Last updated: 2026-02-06.

Condition(s): Pompe Disease (also known as glycogen storage disease type II)
Product: SPK-3006

Primary endpoint: Incidence of adverse and serious adverse events (AEs/SAEs), clinically significant abnormal laboratory values, change in vital signs, change in physical examination (PE), vector shedding in bodily fluids, and liver function tests, Immune responses against the AAV-Spark100 capsid (neutralizing antibody [NAb] assay) and GAA transgene product (binding and NAb assays)
Endpoint(s): Changes from baseline in Six-Minute Walk Test (6MWT), Changes from baseline in % predicted forced vital capacity (FVC), Peak and steady-state vector-derived GAA enzyme levels assessed by total GAA protein and activity measured in circulation, Biomarkers of skeletal muscle injury, glycogen accumulation (creatine kinase [CK], urine glucose tetrasaccharide [Hex4])

Source: https://euclinicaltrials.eu/ctis-public/view/2023-509303-32-00